EU clinical trial 2024-516555-40-00: A Phase II Proof of Concept Multicenter, Randomized, Double-Blind Study to assess the safety and efficacy of Phage Therapy in Patients with Hip or Knee Prosthetic Joint Infection due to Staphylococcus aureus Treated by DAIR
Protocol code: GLORIA - PP-SA-003
Sponsor: Phagenix (Pharmaceutical company). Phase: Therapeutic exploratory (Phase II). Countries: Spain (authorised, recruitment pending), Netherlands (authorised, recruitment pending), France (authorised, recruitment pending).
Therapeutic area(s): Diseases [C] - Bacterial Infections and Mycoses [C01]
Gender: Female, Male. Age: 18-64 years, 65+ years. Enrolment: 51.
Status: Authorised, recruitment pending. Decision date: 2025-03-18. Results received: No. Last updated: 2026-05-28.
Decision dates by country: FR: 2025-03-24, ES: 2025-03-18, NL: 2025-03-18

Condition(s): Hip or Knee prosthetic joint infection due to Staphylococcus aureus
Product: PP1493, PP1815, CHLORURE DE SODIUM FRESENIUS 0,9 %, solution pour perfusion

Primary endpoint: Incidence of serious adverse events up to 3 months, Percentage of Patients with clinical cure up to 3 months
Endpoint(s): Percentage of patients with clinical cure from S.aureus infection up to 3 months and 12 months. Percentage of patients with relapse exclusively due to another germ than Staphylococcus aureus up to 3 month and 12 months, Incidence of all adverse events and assessment of all safety parameters (Vital signs, ECG/ Echocardiography, hematology, hemostasis and biochemistry) up to 3 months and up to 12 months, Percentage of Patient with clinical cure of PJI and up to 12 months., Titration of anti-S. aureus phage antibodies: -In [redacted] at [redacted] in case of relapse and at Early End Visit if it’s occurred before [redacted] for all patients. -In [redacted] at [redacted] in case of relapse if it’s occurred before [redacted] (all patient) and only for knee PJI patients at [redacted]., Quantitative or Semi-Quantitative Analysis of bacterial load at [redacted] (all patient) and only for knee PJI patient at [redacted]., Quantification and identification of polynuclear of [redacted] at [redacted] (all patients) and [redacted] (only knee PJI)., Number and Duration of hospitalization up to 3 months and up to 12 months, Quality-of-life questionnaires [redacted] at [redacted]., [redacted] Questionnaires at [redacted]., X Ray during [redacted] period and at [redacted] to check potential appearance of abnormal loosening (border with shifting of the prosthesis), periprosthetic border.

Source: https://euclinicaltrials.eu/ctis-public/view/2024-516555-40-00